EU clinical trial 2023-506853-39-00: Treatment of adynamic bone disorder with parathyroid hormone in patients with chronic kidney disease
Protocol code: 20192022
Sponsor: Herlev Hospital (Hospital/Clinic/Other health care facility). Phase: Therapeutic use (Phase IV). Countries: Denmark (ongoing, recruiting).
Therapeutic area(s): Diseases [C] - Musculoskeletal Diseases [C05]
Gender: Female, Male. Age: 18-64 years, 65+ years. Enrolment: 48.
Status: Ongoing, recruiting. Start date (EU): 2021-05-20. Decision date: 2023-07-21. Results received: No. Last updated: 2025-09-11.

Condition(s): Adynamic bone disorder
Product: TERIPARATIDE

Primary endpoint: The difference between the two groups (treated versus controls) in changes in BSAP after 18 months
Endpoint(s): Changes between baseline and 18 months as well as differences between treated and untreated in: Number of patients who no longer have adynamic bone disorder based on a BSAP >21 µg/l, Changes between baseline and 18 months as well as differences between treated and untreated in: BMD at the lumbar spine, antebrachium, femoral neck and total hip, Changes between baseline and 18 months as well as differences between treated and untreated in: Incidence of fragility fractures and vertebral fractures assessed using vertebral fracture assessment (VFA) or x-ray of columna, Changes between baseline and 12 months as well as differences between treated and untreated in: Bone microarchitecture, volumetric BMD, bone geometry and bone strength assessed using high-resolution peripheral quantitative computed tomography (HR-pQCT), Changes between baseline and 12 months as well as differences between treated and untreated in: Regional bone formation using 18F-NAF PET/CT, Changes between baseline and 18 months as well as differences between treated and untreated in: P-parathyroid hormone (intact, whole and nonoxidated-PTH), p-ionised calcium, p-phosphate, p-magnesium, p-FGF-23 and p-sclerostin, Changes between baseline and 18 months as well as differences between treated and untreated in: Bone microstructure by micro-computer tomography (µCT) of the bone biopsy, Changes between baseline and 12 months as well as differences between treated and untreated in: Static and dynamic bone histomorphometry classified by the TMV classification assessed by bone biopsy, Changes between baseline and 18 months as well as differences between treated and untreated in: Detailed histology of underlying cellular mechanisms using a combination of immunostainings and advanced in situ hybridizations on the bone biopsy, Changes between baseline and 18 months as well as differences between treated and untreated in: Bone turnover markers i.e. intact PINP, TRAP5b, osteocalcin, RANKL and OPG, Changes between baseline and 18 months as well as differences between treated and untreated in: 24-hour blood pressure and pulse wave measurements including velocity, Changes between baseline and 18 months as well as differences between treated and untreated in: T50, NT-proBNP as well as other cardiovascular biomarkers, Changes between baseline and 18 months as well as differences between treated and untreated in: The incidence of adverse reactions

Source: https://euclinicaltrials.eu/ctis-public/view/2023-506853-39-00